EU clinical trial 2023-503760-17-00: Effects of empagliflozin on plasma glucose in patients with HNF1A-MODY: a randomized, double-blind, crossover trial
Sponsor: Steno Diabetes Center Copenhagen (Hospital/Clinic/Other health care facility). Phase: Therapeutic exploratory (Phase II). Countries: Denmark (ended).
Therapeutic area(s): Diseases [C] - Hormonal diseases [C19]
Gender: Female, Male. Age: 18-64 years, 65+ years. Enrolment: 24.
Status: Ended. Start date (EU): 2023-10-11. End date (EU): 2024-11-29. Decision date: 2023-06-15. Results received: Yes. Last updated: 2024-07-31.

Condition(s): Maturity-onset diabetes of the young type 3 (HNF1A-MODY)
Product: Jardiance 25 mg film-coated tablets, Placebo tablet

Primary endpoint: Mean difference between empagliflozin and placebo in mean sensor glucose measured by continous glucose monitoring (CGM) during the last 10 or 14 (depending on CGM device) days of each treatment period evaluated in principal stratum.
Endpoint(s): CGM: Coefficient of variation (CV%), CGM: standard deviation, CGM: percentage of time in range (3.9–10 mmol/L), CGM: percentage of time above range (>10 mmol/L), CGM: percentage of time below <3.9 mmol/L, CGM: percentage of time below <3.0 mmol/L, Serum (or plasma) fructosamine, Serum (or plasma) glycated albumin, 24h urinary glucose excretion (24h UGE), 24h renal threshold of glucose excretion (estimated using CGM and 24h UGE), Fasting urinary glucose-to-creatine-ratio, Fasting ketone level (self-measured, before clinical visits), Fasting capillary blood glucose (self-measured, before clinical visits), Body weight, Number of hypoglycaemic events and participants with events measured by CGM stratified by severity (level 1, 2, and 3), Number of hypoglycaemic events reported by participants stratified by severity (level 1, 2, and 3), Number of participants with fasting ketone levels ≥0.6 mmol/l, Number of participants with fasting ketone levels ≥1.5 mmol/l

Source: https://euclinicaltrials.eu/ctis-public/view/2023-503760-17-00